EU clinical trial 2023-507899-47-00: A multicenter, single-arm phase II study to assess the safety, tolerability, and efficacy of Isatuximab in adult patients with cytologic or molecular relapsed/refractory CD38 positive T-cell acute lymphoblastic leukemia
Protocol code: GMALL-Isatuximab
Sponsor: Goethe University Frankfurt (Educational Institution). Phase: Therapeutic exploratory (Phase II). Countries: Germany (ongoing, recruiting).
Therapeutic area(s): Diseases [C] - Hemic and Lymphatic Diseases [C15]
Gender: Female, Male. Age: 18-64 years, 65+ years. Enrolment: 40.
Status: Ongoing, recruiting. Start date (EU): 2024-10-22. Decision date: 2024-07-23. Results received: No. Last updated: 2025-12-08.

Condition(s): Cytologic or molecular relapsed/refractory CD38 positive T-cell acute lymphoblastic leukemia
Product: SARCLISA 20mg/mL concentrate for solution for infusion., SARCLISA 20mg/mL concentrate for solution for infusion., SARCLISA 20mg/mL concentrate for solution for infusion., SARCLISA 20mg/mL concentrate for solution for infusion., SARCLISA 20mg/mL concentrate for solution for infusion., DEXAMETHASONE, CYCLOPHOSPHAMIDE, SARCLISA 20mg/mL concentrate for solution for infusion., SARCLISA 20mg/mL concentrate for solution for infusion., SARCLISA 20mg/mL concentrate for solution for infusion., SARCLISA 20mg/mL concentrate for solution for infusion., CYTARABINE, PEGASPARGASE, DEXAMETHASONE, MERCAPTOPURINE, SARCLISA 20mg/mL concentrate for solution for infusion., SARCLISA 20mg/mL concentrate for solution for infusion., METHOTREXATE, METHOTREXATE, DAUNORUBICIN, VINCRISTINE, CYTARABINE, BORTEZOMIB, SARCLISA 20mg/mL concentrate for solution for infusion.

Primary endpoint: Cohort 1: Proportion of patients with complete hematologic response (ORR= CR and CRi) after 2 cycles of induction therapy including Isatuximab (refer to Section 12 for definitions of CR and CRi).
Endpoint(s): Cohort 2: Proportion of patients with molecular response (MolCR) after one cycle of Isatuximab (refer to Section 12 for definitions of molecular response). (Key secondary end point), Proportion of patients with CR and CRi, MolCR and cMolCR in R/R (cohort 1) after 1 or 2 cycles of induction (best response), Probability of continuous complete remission (remission duration) at 18 months, Probability of overall survival at 18 months, Probability of relapse-free survival at 18 months, Probability of event-free survival at 18 months, Incidence of relapses and proportion of relapse localisations, Overall incidence and severity of adverse events (CTCAE 5.0) including incidence of GvHD in patients with prior SCT, Evaluation of overall survival, relapse-free survival, remission duration and treatment related mortality in patients with and without SCT in complete remission after therapy, Duration of molecular remission, Treatment realization for Isatuximab, Probability of continuous MolCR and cMolCR and duration of MolCR and cMolCR, Time to MolCR and cMolCR measured by time-point of first achievement, Realization of SCT in patients with CR (ORR), MolCR, cMolCR, SCT parameters and outcome, Evaluation of all endpoints by T-ALL subgroups, Measurement of Quality of Life with EORTC instruments (e.g. EORTC QLQ-C30) at different time-points during treatment, Hospitalisation days

Source: https://euclinicaltrials.eu/ctis-public/view/2023-507899-47-00